EU clinical trial 2024-512954-96-00: A Phase I/II open label study to assess safety and preliminary evidence of a therapeutic effect of Azeliragon combined with conventional concurrent radiation and temozolomide in patients with newly diagnosed glioblastoma.
Protocol code: CAN-201 NDG
Sponsor: Cantex Pharmaceuticals Inc. (Pharmaceutical company). Phase: Phase I and Phase II (Integrated)- Other. Countries: Spain (ended).
Therapeutic area(s): Diseases [C] - Neoplasms [C04]
Gender: Female, Male. Age: 18-64 years, 65+ years. Enrolment: 32.
Status: Ended. Start date (EU): 2024-05-14. End date (EU): 2026-04-30. Decision date: 2024-05-14. Results received: No. Last updated: 2024-11-11.

Condition(s): Glioblastoma

Source: https://euclinicaltrials.eu/ctis-public/view/2024-512954-96-00